EU clinical trial 2023-509668-11-00: Adjustable brodalumab dosage regimen compared with standard brodalumab treatment for 52 weeks in subjects with moderate-to-severe plaque psoriasis and ≥120 kg body weight; ADJUST - Phase 4 – efficacy, A randomised, double-blind, controlled, parallel group, multi-centre trial
Protocol code: LP0160-1329
Sponsor: Leo Pharma A/S (Pharmaceutical company). Phase: Therapeutic use (Phase IV). Countries: Czechia (ended), Hungary (ended), Italy (ended), Germany (ended), Belgium (ended), Spain (ended), Greece (ended), Poland (ended), France (ended).
Therapeutic area(s): Diseases [C] - Skin and Connective Tissue Diseases [C17]; Diseases [C] - Immune System Diseases [C20]
Gender: Female, Male. Age: 18-64 years, 65+ years. Enrolment: 352.
Status: Ended. Start date (EU): 2022-06-15. End date (EU): 2026-01-05. End date: 2026-01-06. Decision date: 2024-06-06. Results received: Yes. Last updated: 2025-11-21.
Decision dates by country: FR: 2024-06-18, PL: 2024-06-21, IT: 2024-06-12, GR: 2024-07-22, ES: 2024-06-06, BE: 2024-06-06, CZ: 2024-06-10, DE: 2024-06-07, HU: 2024-06-06

Condition(s): Moderate-to-severe plaque psoriasis and a body weight ≥120 kg.
Product: Brodalumab 70 mg, The placebo presentation is a pre-filled syringe containing the same excipients in the same amounts as the IMP, without the active substance., Kyntheum 210 mg solution for injection in pre-filled syringe

Primary endpoint: Having at least 90% lower Psoriasis Area and Severity Index (PASI) score relative to baseline (PASI 90 response) at Week 40.
Endpoint(s): Having static Physician’s Global Assessment (sPGA) score of 0 or 1 at Week 40., Having PASI 90 response at Week 52., Having sPGA score of 0 or 1 at Week 52., Having sPGA of genitalia (sPGA-G) of 0 or 1 at both Weeks 40 and 52., Having sPGA-G score of 0 or 1 at Week 40., Having sPGA-G score of 0 or 1 at Week 52., Having PASI 100 response at Week 40., Having PASI 100 response at Week 52., Change from baseline at Weeks 40 and 52 in PASI score., Change from baseline at Weeks 40 and 52 in affected body surface area (BSA)., Having Dermatology Life Quality Index (DLQI) total score of 0 or 1 at Week 40., Having DLQI total score of 0 or 1 at Week 52., Change from baseline at Weeks 40 and 52 in DLQI total score.

Source: https://euclinicaltrials.eu/ctis-public/view/2023-509668-11-00